EU clinical trial 2024-518430-91-00: A multicenter, randomized, double-blind, parallel, three-arm, active- and placebo-controlled therapeutic equivalence study for the comparison of clindamycin + tretinoin/Verisfield gel (1+0.025)% with Acnatac®/Meda gel [clindamycin + tretinoin (1+0.025)%] in the treatment of acne vulgaris.
Protocol code: CLITRET/VER
Sponsor: Verisfield Single Member S.A. (Pharmaceutical company). Phase: Therapeutic confirmatory (Phase III). Countries: Greece (ended).
Therapeutic area(s): Diseases [C] - Skin and Connective Tissue Diseases [C17]
Gender: Female, Male. Age: 0-17 years, 18-64 years. Enrolment: 300.
Status: Ended. Start date (EU): 2023-06-13. End date (EU): 2025-09-09. End date: 2025-12-06. Decision date: 2025-01-16. Results received: No. Last updated: 2025-04-01.

Condition(s): Acne Vulgaris
Product: Clindamycin + tretinoin/Verisfield gel [10 mg/g (1%) clindamycin (as clindamycin phosphate) + tretinoin 0.25 mg/g (0.025%) gel], Clindamycin +Tretinoin gel, Acnatac 10 mg/g + 0,25 mg/g γέλη

Primary endpoint: Percent change from Baseline to Week 12 in the facial inflammatory (papules and pustules) lesion count in each of the three treatment arms., Percent change from Baseline to Week 12 in the facial noninflammatory (open and closed comedones) lesion count in each of the three treatment arms.
Endpoint(s): Proportions of participants receiving Test and Reference product who have achieved a clinical response of 'success' to therapy at Week 12 according to the IGA scale., Incidence and severity of treatment-emergent serious and nonserious topical and systemic AEs and adverse drug reactions (ADRs) in each of the treatment arms during the 12-week study period., Proportions of participants with application site reactions (i.e., erythema, dryness, burning/stinging, erosion, edema, pain and itching), overall and per type and severity of reaction, in each of the treatment arms during the 12-week study period., Proportions of participants with permanent treatment discontinuations, and reasons for discontinuation in each of the treatment arms during the 12-week study period.

Source: https://euclinicaltrials.eu/ctis-public/view/2024-518430-91-00